EU clinical trial 2024-516996-34-00: GERICO11_Adjuvant systemic treatment for oestrogen-receptor (ER)-positive HER2-negative breast carcinoma in women over 70 according to Genomic Grade (GG): chemotherapy + endocrine treatment versus endocrine treatment. A French UNICANCER Geriatric Oncology Group (GERICO) and Breast Group (UCBG) multicentre phase III trial
Protocol code: UC-0103/1102
Sponsor: Unicancer (Hospital/Clinic/Other health care facility). Phase: Therapeutic confirmatory (Phase III). Countries: Belgium (ongoing, recruitment ended), France (ongoing, recruitment ended).
Therapeutic area(s): Diseases [C] - Neoplasms [C04]
Gender: Female. Age: 65+ years. Enrolment: 1989.
Status: Ongoing, recruitment ended. Start date (EU): 2012-04-12. Decision date: 2024-09-17. Results received: No. Last updated: 2024-10-31.
Decision dates by country: BE: 2024-09-17, FR: 2024-10-31

Condition(s): oestrogen-receptor (ER)-positive HER2-negative breast carcinoma
Product: CYCLOPHOSPHAMIDE, Myocet liposomal 50 mg powder, dispersion and solvent for concentrate for dispersion for infusion., DOXORUBICIN, DOCETAXEL

Primary endpoint: Overall Survival (OS) with 4 years of follow-up (ie median follow-up = 4 years)
Endpoint(s): Breast cancer-specific survival (BCSS), Invasive disease-free survival (iDFS), Event-free survival (EFS), Relapse-free survival (RFS), Evaluation of Toxicity, Quality of life: Quality of life (QoL) will be assessed using the national version of EORTC QLQ-C30 (version 3) and QLQ-ELD15, a QLQ C30 supplement module for the assessment of quality of life in the elderly patient with cancer, Q-TWiST analysis, Geriatric assessment, Treatment acceptability, Predictive value of a 4-year mortality score, Usefulness of GG by RT-PCR as a prognostic signature and performance in an elderly population by comparison to standardized routine histopathological criteria and to the results obtained in the general non elderly population, Cost-effectiveness analysis, Follow-up of a cohort of elderly BC patients not treated with adjuvant chemotherapy (including non eligibility due to GG)., Ancillary study criterai (Only applicable for France): The prognostic value of HalioDx GG testing on iDFS and D-DFS/D-RFS will be assessed in the first 500 patients in the screened population (cohort group and randomized group [in both arms]) with a follow-up of 36 months.

Source: https://euclinicaltrials.eu/ctis-public/view/2024-516996-34-00